EU clinical trial 2022-501894-37-00: "APalutamide and stEReotactic body radiation therapy for low burden metastatic hormone senSItive prostate cancer, a rANdomized trial -PERSIAN".
Protocol code: PERSIAN
Sponsor: Fondazione Radioterapia Oncologica Onlus (Hospital/Clinic/Other health care facility). Phase: Therapeutic exploratory (Phase II). Countries: Italy (ongoing, recruiting).
Therapeutic area(s): Diseases [C] - Neoplasms [C04]
Gender: Male. Age: 18-64 years, 65+ years. Enrolment: 180.
Status: Ongoing, recruiting. Start date (EU): 2023-03-02. Decision date: 2023-02-20. Results received: No. Last updated: 2025-05-05.

Condition(s): prostate cancer
Product: APALUTAMIDE

Primary endpoint: Rate of patients with complete biochemical response (PSA < 0.2 ng/ml) at 6 months after treatment start
Endpoint(s): Freedom from biochemical progression according to Prostate Cancer Working Group Criteria, Freedom from radiological progression according to Prostate Cancer Working Group Criteria, Rate of adverse events, measured according to Common Terminology Criteria for Adverse Events, Overall Survival, Cancer Specific Survival, Health related quality of life measured with EORTC QLQ-C30 and QLQ-PR25 questionnaires

Source: https://euclinicaltrials.eu/ctis-public/view/2022-501894-37-00